EU clinical trial 2022-501100-94-00: A Phase 3, Multicenter, 12-Week, Double Blind, Placebo-Controlled Study to Evaluate the Safety and Efficacy of Atogepant for the Preventive Treatment of Episodic Migraine in Pediatric Subjects 6 to 17 years of age
Protocol code: M21-201
Sponsor: Abbvie Deutschland GmbH & Co. KG (Pharmaceutical company). Phase: Therapeutic confirmatory (Phase III). Countries: Sweden (ongoing, recruiting), Hungary (ongoing, recruiting), Belgium (ongoing, recruiting), Denmark (ongoing, recruiting), Italy (ongoing, recruiting), France (ended), Poland (ongoing, recruiting), Romania (ended), Spain (ongoing, recruiting), Netherlands (ongoing, recruiting).
Therapeutic area(s): Diseases [C] - Nervous System Diseases [C10]
Gender: Female, Male. Age: 0-17 years. Enrolment: 163.
Start date (EU): 2023-11-08. Decision date: 2023-07-31. Results received: No. Last updated: 2026-05-18.
Decision dates by country: RO: 2023-08-07, ES: 2023-08-02, PL: 2023-08-07, BE: 2023-07-31, SE: 2023-08-02, DK: 2023-08-01, HU: 2023-08-04, FR: 2023-08-07, IT: 2023-08-04, NL: 2023-08-22

Condition(s): Episodic Migraine
Product: Atogepant, Atogepant, Atogepant, Placebo for Atogepant tablets 10mg, Placebo for Atogepant tablets 60mg

Primary endpoint: Change from baseline in mean monthly migraine days across the 12-week treatment period.
Endpoint(s): Change from baseline in mean monthly headache days across the 12-week treatment period., Change from baseline in mean monthly acute medication use days across the 12-week treatment period., Achievement of at least a 50% reduction in 3-month average of monthly migraine days., Change from baseline in the PedsQL total score at Week 12., Change from baseline in the PedMIDAS total score at Week 12., Change from baseline in mean monthly headache days of at least moderate severity across the 12-week treatment period.

Source: https://euclinicaltrials.eu/ctis-public/view/2022-501100-94-00